EU clinical trial 2023-510204-50-00: Phase I/II clinical trial of autologous hematopoietic stem cell gene therapy in rag1-deficient severe combined immunodeficiency
Protocol code: RAG1
Sponsor: Videja B.V. (Pharmaceutical company). Phase: Human Pharmacology (Phase I)- Other. Countries: Netherlands (temporarily halted), Italy (ended), Poland (temporarily halted), Spain (temporarily halted).
Therapeutic area(s): Diseases [C] - Immune System Diseases [C20]
Gender: Female, Male. Age: 0-17 years. Enrolment: 6.
Start date (EU): 2021-07-23. Decision date: 2024-11-04. Results received: No. Last updated: 2025-11-19.
Decision dates by country: IT: 2024-12-09, PL: 2024-11-07, ES: 2024-11-05, NL: 2024-11-04

Condition(s): Severe combined immunodeficiency based on genetic defect in the Recombinase Activating Gene 1 (RAG1)
Product: RAG1-LV-CD34+ cells

Primary endpoint: Overall survival Evaluation of immune reconstitution at Month 6 defined as -Presence of naive CD4+ T cells -Total CD3+ T-cells > 300 cells/µL -Total CD4+ T-cells > 200 cells/µL
Endpoint(s): Event-free survival (survival without the need for rescue treatment defined as infusion of autologous unmanipulated backup stem cell product and/or allogeneic HSCT), Independence from immunoglobulin substitution at Month 24, Serologic response to vaccination, Immune system reconstitution o T-cell repopulation: -Total CD3+ T-cells > 300 cells/µL (at Month 12, 18, 24, 30, 36, 42, 48, 54, 60) - Total CD4+ T-cells > 200 cells/µL (at Month 12, 18, 24, 30, 36, 42, 48, 54, 60) - Presence of naive CD4+ T cells (at Month 12, 18, 24, 30, 36, 42, 48, 54, 60), o B-cell repopulation: - Total B-cell counts (at Month 6, 12, 18, 24, 30, 36, 42, 48, 54, 60) - Memory B-cell count (at Month 6, 12, 18, 24, 30, 36, 42, 48, 54, 60) - Switched memory B-cell count (at Month 6, 12, 18, 24, 30, 36, 42, 48, 54, 60), o Immune function: - Level of IgG (at Month 6, 12, 18, 24, 36, 48, 60) - Level of IgA (at Month 6, 12, 18, 24, 36, 48, 60) - Level of IgM (at Month 6, 12, 18, 24, 36, 48, 60) - IG repertoire and T cell receptor (TCR) repertoire on PBMCs at Month 12, Pharmacodynamics o Vector copy number (VCN) in PBMCs and granulocytes o TRECs and KRECs, Quality of Life: Change from baseline in PedsQL

Source: https://euclinicaltrials.eu/ctis-public/view/2023-510204-50-00